EU clinical trial 2024-513579-42-00: A Phase 1/2a Dose-Escalating Study to Evaluate the Safety, Tolerability, Pharmacokinetics, and Pharmacodynamics of ARO-DM1 in Subjects With Type 1 Myotonic Dystrophy Who are ≥18 to ≤65 Years
Protocol code: ARODM1-1001
Sponsor: Sarepta Therapeutics Inc. (Pharmaceutical company). Phase: Phase I and Phase II (Integrated)- First administration to humans. Countries: Spain (authorised, recruitment pending), Germany (authorised, recruitment pending), Belgium (authorised, recruitment pending), Italy (authorised, recruitment pending).
Therapeutic area(s): Diseases [C] - Nervous System Diseases [C10]
Gender: Female, Male. Age: 18-64 years. Enrolment: 58.
Status: Authorised, recruitment pending. Decision date: 2026-01-29. Results received: No. Last updated: 2026-05-25.
Decision dates by country: DE: 2026-01-29, ES: 2026-02-03, BE: 2026-01-30, IT: 2026-01-30

Condition(s): Type 1 Myotonic Dystrophy
Product: Placebo - Sodium Chloride 9 mg/ml (0.9%) - Solution for injection, ARO-DM1

Primary endpoint: Incidence, frequency, and severity of treatment-emergent adverse events (TEAEs) and treatment-related AEs in subjects with DM1 over time through the end of study (EOS)
Endpoint(s): Plasma PK of ARO-DM1 in subjects with DM1.

Source: https://euclinicaltrials.eu/ctis-public/view/2024-513579-42-00